EU clinical trial 2023-504555-27-00: Phase III study comparing GVHD prophylaxis with ATG-thymoglobulin to ATLG-grafalon in elderly patients with acute myeloid leukemia or myelodysplastic syndrome and receiving an allogeneic hematopoietic stem cell transplantation with a 10/10 HLA matched unrelated donor following a reduced intensity conditioning regimen by fludarabine-treosulfan (OPTISAGE)
Protocol code: APHP230276
Sponsor: Assistance Publique Hopitaux De Paris (Hospital/Clinic/Other health care facility). Phase: Therapeutic confirmatory (Phase III). Countries: France (ongoing, recruiting), Belgium (authorised, recruitment pending).
Therapeutic area(s): Diseases [C] - Immune System Diseases [C20]
Gender: Female, Male. Age: 18-64 years, 65+ years. Enrolment: 334.
Start date (EU): 2023-11-28. Decision date: 2023-09-29. Results received: No. Last updated: 2026-07-15.
Decision dates by country: FR: 2023-09-29, BE: 2026-07-15

Condition(s): Myelodysplastic syndrome (MDS), Acute myeloid leukemia (AML)
Product: Grafalon 20 mg/ml solution à diluer pour perfusion., THYMOGLOBULINE 5 mg/ml, poudre pour solution pour perfusion, MYCOPHENOLATE MOFETIL, TREOSULFAN, FLUDARABINE, CICLOSPORIN

Primary endpoint: Incidence of grade II-IV acute GVHD according to the MAGIC classification (Appendix 19.9 section 1) at day 100 post-transplantation.
Endpoint(s): Hematopoietic recoveries: at least 7 consecutive days with neutrophils > 0.5 G/L, with platelets > 20 G/L, Immune reconstitution by analyzing T, B, NK, regulatory T cell and gammaglobulin levels in the peripheral blood at M1, D+100, M6, M12 and M24 post-transplantation, Chimerism at M1, D+100, M6, M12, Grade I acute GVHD incidence (Appendix 19.9 section 1) and acute GvHD treatments: first line treatment, response to steroids, treatment courses for refractory acute GVHD, Chronic GvHD incidence (date and grading) at M12 and M24 (NIH classification, Appendix 19.9 section 4), Relapse incidence at M12 and M24 (relapse will be defined by the reappearance of leukemic cells or MDS features after allo-HSCT in the bonne marrow (cytology +/- cytogenetic analysis from bone marrow aspiration) or extra-medullary sites (proven by a biopsy)., Progression free survival at M12 and M24, Severe infections (CTAE grade 3-4) at D+100 and M12 will be fully described, Incidences of CMV and EBV reactivations at D+100, M6 and M12, Non-relapse mortality at M6, M12 and M24, Overall survival at M12 and M24, GVHD and relapse free survival (GRFS) defined by being alive without disease relapse and without having developed acute grade III-IV or severe chronic GVHD, Health-related Quality of life, assessed by using theFACT-BMT-v4 questionnaire at inclusion and at D+100, M6, M12 post-transplantation, Number of days of hospitalization for the transplant and after the hospitalization for transplantation related complications until M12, Incidence and severity of VOD at D+100, Lymphocyte counts on standard blood counts before conditioning (D-7), Late acute GvHD, overlap syndromes and chronic GvHD at D+120.

Source: https://euclinicaltrials.eu/ctis-public/view/2023-504555-27-00